EU clinical trial 2024-516902-46-00: EEG-MRI Study of the Effect of Methylphenidate on Neural Mechanisms in Adult Patients With ADHD With or Without Mood Disorders: a Randomized Controlled Trial Versus Placebo
Protocol code: 7347
Sponsor: Les Hopitaux Universitaires De Strasbourg (Hospital/Clinic/Other health care facility). Phase: Phase II and Phase III (Integrated). Countries: France (ongoing, recruiting).
Therapeutic area(s): Psychiatry and Psychology [F] - Behavioral Disciplines and Activities [F04]
Gender: Female, Male. Age: 18-64 years. Enrolment: 80.
Status: Ongoing, recruiting. Start date (EU): 2024-09-19. Decision date: 2024-09-19. Results received: No. Last updated: 2024-09-19.

Condition(s): Attention Deficit Hyperactivity Disorder (ADHD)
Product: RITALINE 10 mg, comprimé sécable, FORMULE 515 AP-HP (placebo)- préparation hospitalière

Primary endpoint: Effect of methylphenidate on the task vs. rest in a region defined by its involvement in the cognitive task and its reactivity to methylphenidate. ROI (Region of Interest) analysis to maximize power.
Endpoint(s): Decrease in rCBF (regional Cerebral Blood Flow) in the methylphenidate condition vs. placebo, in the different groups., Improved cognitive performance on tests of sustained attention, working memory and flexibility following the administration of methylphenidate, in the different groups., Stabilization of the power of the EEG spectrum in the low frequencies (delta (1-4Hz) and theta (4-8Hz)) in the methylphenidate condition vs. placebo., MRI: Interaction group x treatment x task on cerebral activation linked to sustained attention and linked to the inhibition corresponding to each of these tasks., EEG: Group x treatment x task interaction on the amplitude of the XML File Identifier: 0Vmd7NrSRK8JeP+9ISLPaO9Oq+U= Page 14/26 P300 wave linked to sustained attention (P300b) and linked to inhibition (P300a) corresponding to each of these tasks.

Source: https://euclinicaltrials.eu/ctis-public/view/2024-516902-46-00